EU clinical trial 2024-516992-33-02: CLASP MS: The study evaluating the efficacy and safety of Polish cladribine in the treatment of patients with secondary progressive multiple sclerosis - a phase 2, randomized, double-blind, placebo-controlled trial.
Protocol code: 504-15-021-21003
Sponsor: Instytut Psychiatrii I Neurologii (Educational Institution). Phase: Therapeutic exploratory (Phase II). Countries: Poland (ongoing, recruitment ended).
Therapeutic area(s): Diseases [C] - Nervous System Diseases [C10]
Gender: Female, Male. Age: 18-64 years. Enrolment: 188.
Status: Ongoing, recruitment ended. Start date (EU): 2025-01-30. Decision date: 2025-01-30. Results received: No. Last updated: 2025-01-30.

Condition(s): Multiple sclerosis secondary progressive form
Product: BIODRIBIN, 1 mg/ml, roztwór do infuzji, 0.9% physiological saline (sodium chloride)

Primary endpoint: Percent brain volume change from last cladribine dose (week 26) to end of study (week 122).
Endpoint(s): 1.Time to 24-week confirmed composite progression of disability defined as the occurrence of any of the following events: an increase in EDSS score, in time of Timed 25-Foot Walk and 9-Hole Peg Test. 2.Change from baseline in cognitive function (CANTAB, CVLT, SDMT) and quality of life (MSQeL-54) 3.Neuroimaging: number of Gd+ lesions, new T2 lesions, QSM rim+ lesions, volume of T1 lesions (black holes), volume of cervical spinal cord in T1; 4. Serum level of NfL, GFAP, oligoclonal bands presence

Source: https://euclinicaltrials.eu/ctis-public/view/2024-516992-33-02